EU clinical trial 2022-500079-30-00: A Phase 3, Multicenter, Randomized, Double-blind, Placebo-controlled Trial to Evaluate the Efficacy and Safety of Sibeprenlimab Administered Subcutaneously in Subjects with Immunoglobulin A Nephropathy
Protocol code: 417-201-00007
Sponsor: Otsuka Pharmaceutical Development And Commercialization Inc. (Pharmaceutical company). Phase: Therapeutic confirmatory (Phase III). Countries: Croatia (ended), Spain (ended), Greece (ended), Italy (ended), Czechia (ended), France (ended), Belgium (ended), Germany (ended), Hungary (ended), Poland (ended), Netherlands (ended), Portugal (ended).
Therapeutic area(s): Diseases [C] - Immune System Diseases [C20]; Diseases [C] - Female Urogenital Diseases and Pregnancy Complications [C13]; Diseases [C] - Male Urogenital Diseases [C12]
Gender: Female, Male. Age: 18-64 years, 65+ years. Enrolment: 99.
Status: Ended. Start date (EU): 2022-11-03. End date (EU): 2026-05-07. End date: 2026-05-13. Decision date: 2022-08-31. Results received: No. Last updated: 2026-05-13.
Decision dates by country: PT: 2023-02-20, DE: 2022-08-31, HR: 2022-09-01, BE: 2022-09-05, HU: 2022-09-02, CZ: 2022-09-05, FR: 2022-09-05, GR: 2022-09-02, PL: 2022-09-05, IT: 2022-09-02, NL: 2022-09-05, ES: 2022-09-16

Condition(s): IgA Nephropathy
Product: Sibeprenlimab, Sibeprenlimab-matching Placebo, Sibeprenlimab

Primary endpoint: Primary Efficacy: Ratio of uPCR at 9 months compared with baseline, based on 24-hour urine collection.
Endpoint(s): The annualized slope of eGFR estimated over the course of approximately 24 months., Efficacy: Mean change of eGFR from baseline at 24 months., Efficacy: Progression to CKF, as assessed by: Time to progression to CKF (time from the randomization date to first occurrence of CKF); Proportion of subjects with progression to CKF., Change from baseline in total serum IgA, IgG, and IgM concentration, Safety: Incidence of TEAEs graded by severity, clinical laboratory tests, vital sign measurements, 12 lead ECGs, physical examinations, and injection site reactions., Other: Evaluation of serum ADA.

Source: https://euclinicaltrials.eu/ctis-public/view/2022-500079-30-00